EU clinical trial 2025-524733-11-00: A Single-center, Prospective, Non-randomized, Open, Pilot Study Evaluating the Safety and Performance of the Extroducer® Infusion Catheter System for Peri/Intratumoral Gemcitabine Delivery in Patients with Unresectable Locally Advanced Pancreatic Cancer
Protocol code: nEXT-GEM
Sponsor: Smartwise Sweden AB (Pharmaceutical company). Phase: Phase I and Phase II (Integrated)- Other. Countries: Sweden (ongoing, recruiting).
Therapeutic area(s): Diseases [C] - Digestive System Diseases [C06]; Diseases [C] - Neoplasms [C04]
Gender: Female, Male. Age: 18-64 years, 65+ years. Enrolment: 9.
Status: Ongoing, recruiting. Start date (EU): 2026-04-22. Decision date: 2026-02-20. Results received: No. Last updated: 2026-04-27.

Condition(s): Unresectable Locally Advanced Pancreatic Cancer
Product: Gemcitabin Sandoz 40 mg/ml koncentrat till infusionsvätska, lösning

Primary endpoint: Occurrence of Extroducer® related Serious Adverse Events within 72 hours post Extroducer® treatment infusion with Gemcitabine.
Endpoint(s): Occurrence of Gemcitabine related Serious Adverse Events from first Extroducer® treatment infusion with Gemcitabine until study completion., Survival rates (Overall Survival (OS) and Progression Free Survival (PFS)) at 6 months after final Extroducer® treatment infusion with Gemcitabine., Classification of tumor resectability according to NCCN resectability criteria before (baseline) and after (Visits 11-13) Extroducer® treatment infusion with Gemcitabine., Classification of tumor response according to RECIST before (baseline) and after (Visits 11-13) Extroducer® treatment infusion with Gemcitabine., Evaluation of the tumor marker CA-19-9 before (baseline) and after (Visits 9, 11-13) Extroducer® treatment infusion with Gemcitabine., Evaluation of subjects’ quality of life using the EORTC QLQ-C30 and PANC26 questionnaires before (baseline) and after (Visits 11-13) Extroducer® treatment infusion with Gemcitabine., The incidence, severity, and seriousness of Adverse Events and Device Deficiencies throughout the clinical investigation.

Source: https://euclinicaltrials.eu/ctis-public/view/2025-524733-11-00